EU clinical trial 2022-501461-52-00: A parallel-group treatment, proof-of-concept Phase 2, multicenter, double-blind, randomized 2 arm clinical trial to investigate the efficacy and safety of subcutaneous NT 201 injections compared with placebo injections in decreasing pain intensity in male and female participants aged 18 years and older with moderate or severe chronic neuropathic pain due to postherpetic neuralgia or peripheral nerve injury.
Protocol code: M602011079
Sponsor: Merz Therapeutics GmbH (Pharmaceutical company). Phase: Therapeutic exploratory (Phase II). Countries: Germany (ended), Bulgaria (ended), Spain (ended), Hungary (ended), France (ended), Poland (ended).
Therapeutic area(s): Diseases [C] - Nervous System Diseases [C10]
Gender: Female, Male. Age: 18-64 years, 65+ years. Enrolment: 120.
Status: Ended. Start date (EU): 2023-10-17. End date (EU): 2025-06-16. Decision date: 2023-04-18. Results received: Yes. Last updated: 2025-03-21.
Decision dates by country: FR: 2023-04-18, DE: 2023-04-21, PL: 2023-04-24, BG: 2023-04-24, HU: 2023-04-21, ES: 2023-04-19

Condition(s): Moderate to severe chronic peripheral neuropathic pain (PNP) due to postherpetic neuralgia (PHN) or peripheral nerve injury.
Product: XEOMIN 100 Einheiten Pulver zur Herstellung einer Injektionslösung, Placebo to NT 201, CLOSTRIDIUM BOTULINUM NEUROTOXIN TYPE A (150KD), FREE OF COMPLEXING PROTEINS, PARACETAMOL

Primary endpoint: Weekly averages of changes from baseline in ADP intensity at Weeks 2 to 12.
Endpoint(s): Changes from baseline in NPSI total score at Weeks 2 to 12., Incidence of treatmentemergent adverse events (TEAEs) related to study intervention as assessed by the investigator from intervention to end of study.

Source: https://euclinicaltrials.eu/ctis-public/view/2022-501461-52-00